EU clinical trial 2024-518843-39-00: Mass balance study of [14C]-VAD044
Protocol code: VAD044C003
Sponsor: Vaderis Therapeutics AG (Pharmaceutical company). Phase: Human Pharmacology (Phase I)- Other. Countries: Netherlands (ended).
Therapeutic area(s): Diseases [C] - Cardiovascular Diseases [C14]
Gender: Male. Age: 18-64 years. Enrolment: 7.
Status: Ended. Start date (EU): 2024-12-31. End date (EU): 2025-03-03. End date: 2025-03-04. Decision date: 2024-12-23. Results received: No. Last updated: 2024-12-31.
Decision dates by country: NL: 2024-12-31

Condition(s): Vascular malformation

Source: https://euclinicaltrials.eu/ctis-public/view/2024-518843-39-00